EU clinical trial 2024-519845-30-00: Phase I / II clinical trial, randomized, exploratory and prospective to evaluate the safety and efficacy of the transfusion of autologous TREG cells obtained from thymic tissue in the prevention of rejection in heart transplanted children
Protocol code: THYTECH1-2018-005
Sponsor: Fundacion Para La Investigacion Biomedica Del Hospital Gregorio Maranon (Hospital/Clinic/Other health care facility). Phase: Human Pharmacology (Phase I)- First administration to humans. Countries: Spain (ongoing, recruiting).
Therapeutic area(s): Diseases [C] - Immune System Diseases [C20]
Gender: Female, Male. Age: 0-17 years. Enrolment: 11.
Status: Ongoing, recruiting. Start date (EU): 2025-01-30. Decision date: 2025-01-30. Results received: No. Last updated: 2025-01-30.

Condition(s): To evaluate the efficacy in the prevention of the rejection of the transfusion of autologous thyTreg cells in children transplanted from the heart
Product: Células linfocíticas Treg, diferenciadas, autólogas, de tejido tímico, expandidas y estimuladas con IL-2 (thyTreg)

Primary endpoint: Repopulation of Treg cells in the patient, determined as the increase of their blood values and the recovery of the ratio Treg / T-effector cells with respect to the values prior to transplantation
Endpoint(s): Incidence of episodes of acute myocardial rejection (diagnosed by echocardiography and / or biopsy) that requires treatment in the 2 years post-transplant, Restoration of immunological homeostasis in terms of values of immune populations. The percentages and absolute values of T, B, NK and Treg lymphoid populations and of monocytes, dendritic cells and granulocytes during the post-transplant follow-up period (+7, +14, +21, +30, +60, +90, +120, +150, +180, +270, +365, +545, +730 days), Survival of the patient, Security (according to criteria NCI-CTCAE V4.03)

Source: https://euclinicaltrials.eu/ctis-public/view/2024-519845-30-00